EU clinical trial 2023-503718-66-00: Intravesical Mistletoe Extract in Superficial Bladder Cancer: A Phase III Efficacy Study
Protocol code: Study-AB03
Sponsor: Abnoba GmbH (Pharmaceutical company). Phase: Therapeutic confirmatory (Phase III). Countries: Germany (ended).
Therapeutic area(s): Diseases [C] - Neoplasms [C04]
Gender: Female, Male. Age: 18-64 years, 65+ years. Enrolment: 522.
Status: Ended. Start date (EU): 2015-02-11. End date (EU): 2026-04-24. Decision date: 2023-06-28. Results received: No. Last updated: 2024-01-23.

Condition(s): Male and female patients aged ≥ 18 to ≤ 85 years with a completely resected superficial bladder cancer (Stage Ta tumors) with a classification of intermediate-risk according to the EAU and without CIS and/or G3 tumors after a TURB and one immediately post-operative intravesical instillation of MMC 40 mg or epirubicin 50 mg (only Poland).
Product: abnobaVISCUM Fraxini 20 mg Injektionslösung Wirkstoff: Auszug aus frischem Eschenmistelkraut, MITOMYCIN

Primary endpoint: The primary endpoint of the study will be the time to tumor recurrence. Should a recurrence of the bladder carcinoma be recorded, the patient will be withdrawn from study treatment.
Endpoint(s): The secondary objective, namely safety including toxicity and tolerability of the study medication, will be assessed by the monitoring of adverse events (AEs) according to the Common Terminology Criteria for Adverse Events (CTCAE), laboratory assessments (hematology, biochemistry and urinalysis) and a global judgment of tolerability., Secondary efficacy endpoints: prognosis after 1 year for recurrence and progression, estimated by the European Organization for Research and Treatment of Cancer (EORTC) Bladder Cancer Calculator, tumor grading, Quality of Life (EORTC QLQ-C30 and BLS24)

Source: https://euclinicaltrials.eu/ctis-public/view/2023-503718-66-00